EU clinical trial 2024-511051-18-00: A Randomized, Blinded, Placebo-Controlled Dose-Ranging Phase 1b Study of the Safety, Pharmacokinetics, and Antiviral Activity of ABI-4334 in Subjects with Chronic Hepatitis B Virus Infection
Protocol code: ABI-4334-102
Sponsor: Assembly Biosciences Inc. (Pharmaceutical company). Phase: Human Pharmacology (Phase I)- Other. Countries: Bulgaria (ended), Romania (ended).
Therapeutic area(s): Diseases [C] - Virus Diseases [C02]
Gender: Female, Male. Age: 18-64 years. Enrolment: 22.
Status: Ended. End date (EU): 2025-02-12. End date: 2025-05-14. Decision date: 2024-07-30. Results received: No. Last updated: 2024-09-26.
Decision dates by country: BG: 2024-07-30, RO: 2024-07-30

Condition(s): chronic hepatitis B virus infection (cHBV)

Source: https://euclinicaltrials.eu/ctis-public/view/2024-511051-18-00